EU clinical trial 2023-506558-20-00: Phase 3, randomized, double-blind, placebo-controlled, parallel-group, 3-arm, multinational, multicenter study to evaluate the efficacy and safety of amlitelimab by subcutaneous injection in participants aged 12 years and older with moderate-to-severe atopic dermatitis on background topical corticosteroids - EFC17561 - SHORE
Protocol code: EFC17561
Sponsor: Sanofi-Aventis Recherche & Developpement (Pharmaceutical company). Phase: Therapeutic confirmatory (Phase III). Countries: Italy (ended), Germany (ended), Czechia (ended), Spain (ended), France (ended), Bulgaria (ended).
Therapeutic area(s): Diseases [C] - Skin and Connective Tissue Diseases [C17]
Gender: Female, Male. Age: 0-17 years, 18-64 years, 65+ years. Enrolment: 216.
Status: Ended. Start date (EU): 2024-06-26. End date (EU): 2025-10-13. End date: 2025-11-01. Decision date: 2024-06-11. Results received: No. Last updated: 2026-01-29.
Decision dates by country: DE: 2024-06-11, FR: 2024-06-11, ES: 2024-06-11, BG: 2024-06-17, IT: 2024-06-11, CZ: 2024-06-11

Condition(s): Dermatitis atopic
Product: PIMECROLIMUS, Amlitelimab, Placebo, Amlitelimab, TACROLIMUS

Primary endpoint: EU, EU reference countries, and Japan: Proportion of participants with Validated Investigator Global Assessment scale for Atopic Dermatitis (vIGA-AD) of 0 (clear) or 1 (almost clear) and a reduction from baseline of ≥2 points at Week 24, EU, EU reference countries, and Japan: Proportion of participants reaching 75% reduction from baseline in Eczema Area and Severity Index (EASI) score (EASI-75) at Week 24, US and US reference countries: Proportion of participants with vIGA-AD of 0 (clear) or 1 (almost clear) and a reduction from baseline of ≥2 points at Week 24
Endpoint(s): Proportion of participants reaching EASI-75 at Week 24 (for US and US reference countries only), Proportion of participants with vIGA-AD 0 (clear) or 1 (almost clear) with presence of only barely perceptible erythema (no induration/papulation, no lichenification, no oozing or crusting) and a reduction from baseline of ≥2 points, Proportion of participants with ≥4-point reduction in weekly average of daily Peak Pruritus-Numerical Rating Scale (PP-NRS) from baseline in participants with baseline weekly average of daily PP-NRS ≥4, Proportion of participants reaching EASI-75, Proportion of participants with vIGA-AD of 0 (clear) or 1 (almost clear) and a reduction from baseline of ≥2 points, Proportion of participants reaching EASI-90, Proportion of participants reaching EASI-100, Proportion of participants with PP-NRS 0 or 1, Change in Dermatology Life Quality Index (DLQI) from baseline in participants with age ≥16 years old, Proportion of participants with a reduction in DLQI ≥4 from baseline in participants with age ≥16 years old and with DLQI baseline ≥4, Change in Children Dermatology Life Quality Index (CDLQI) from baseline in participants with age ≥12 to <16 years old, Proportion of participants with a reduction in CDLQI ≥6 from baseline in participants with age ≥12 to <16 years old and with CDLQI baseline ≥6, Change in Hospital Anxiety Depression Scale (HADS) from baseline, Proportion of participants with HADS subscale Anxiety (HADS-A) <8 in participants with baseline HADS-A ≥8, Proportion of participants with HADS subscale Depression (HADS-D) <8 in participants with HADS-D baseline ≥8, Absolute change in weekly average of daily Skin Pain-Numerical Rating Scale (SP-NRS) from baseline, Proportion of participants with a reduction in weekly average of daily SP-NRS ≥4 from baseline in participants with baseline weekly average of daily SP-NRS ≥4, Absolute change in weekly average of daily Sleep Disturbance-Numerical Rating Scale (SD-NRS) from baseline, Proportion of participants with a reduction in weekly average of daily SD-NRS ≥3 from baseline in participants with Baseline weekly average of daily SD-NRS ≥3, Percent change in weekly average of daily SP-NRS from baseline, Percent change in weekly average of daily SD-NRS from baseline, Percent change in EASI score from baseline, Percent change in weekly average of daily PP-NRS from baseline, Absolute change in weekly average of daily PP-NRS from baseline, Proportion of participants reaching EASI-50, Proportion of participants with EASI ≤7, Change in percent Body Surface Area (BSA) affected by AD from baseline, Percent change in Scoring Atopic Dermatitis (SCORAD) index from baseline, Absolute change in Scoring Atopic Dermatitis (SCORAD) index from baseline, Proportion of participants with a reduction in SCORAD ≥ 8.7 points from baseline in participants with baseline SCORAD score ≥ 8.7, Change in Patient Oriented Eczema Measure (POEM) from baseline, Proportion of participants with a reduction in POEM ≥4 from baseline in participants with POEM Baseline ≥4, Proportion of participants with rescue medication use, Cumulative amount of topical corticosteroids (TCS) consumption, Percentage of TCS/topical calcineurin inhibitors (TCI) free days, Percentage of participants who experience Treatment-Emergent Adverse Events (TEAEs), experience Treatment-Emergent Serious Adverse Events (TESAEs) and/or Treatment- Emergent Adverse Events of Special Interest (AESI), Serum amlitelimab concentrations, Incidence of antidrug antibodies (ADAs) of amlitelimab, Proportion of participants with vIGA-AD 0 (clear)

Source: https://euclinicaltrials.eu/ctis-public/view/2023-506558-20-00